EU clinical trial 2023-508158-24-00: A Phase 2, Randomized, Double-blind, Placebo-controlled Study to Evaluate the Safety and Efficacy of 3 Active Dose Regimens of MORF-057 in Adults with Moderately to Severely Active Crohn’s Disease (GARNET)
Protocol code: MORF-057-203
Sponsor: Morphic Therapeutic Inc. (Pharmaceutical company). Phase: Therapeutic exploratory (Phase II). Countries: Czechia (ongoing, recruiting), Italy (ongoing, recruiting), Germany (ongoing, recruiting), Latvia (ongoing, recruiting), Poland (ongoing, recruitment ended), Hungary (ongoing, recruiting), Slovakia (ongoing, recruiting), France (ongoing, recruiting), Spain (ongoing, recruiting), Croatia (ongoing, recruiting), Austria (ongoing, recruiting), Romania (ongoing, recruiting), Estonia (authorised, recruitment pending), Bulgaria (authorised, recruitment pending).
Therapeutic area(s): Diseases [C] - Digestive System Diseases [C06]
Gender: Female, Male. Age: 18-64 years, 65+ years. Enrolment: 209.
Start date (EU): 2024-06-25. Decision date: 2024-05-22. Results received: No. Last updated: 2026-08-03.
Decision dates by country: CZ: 2024-05-23, FR: 2024-05-23, HR: 2024-05-23, LV: 2024-05-22, HU: 2024-05-22, AT: 2024-05-27, SK: 2024-05-22, RO: 2024-05-24, PL: 2024-05-27, EE: 2026-07-20, BG: 2026-08-03, DE: 2024-05-23, ES: 2024-05-22, IT: 2024-05-24

Condition(s): Moderately to Severely Active Crohn’s Disease
Product: Placebo for MORF-057, capsule, MORF-057 IR Capsule

Primary endpoint: Primary efficacy: Proportion of participants with endoscopic response as determined using the Simple Endoscopic Score-CD (SES-CD) at Week 14.
Endpoint(s): Secondary efficacy: - Proportion of participants with clinical response as determined using the CDAI at Week 14; - Proportion of participants with clinical remission as determined using the CDAI at Week 14., Safety: Frequencies and proportions of treatment-emergent adverse events (TEAEs), treatment-emergent serious adverse events (TESAEs), and TEAEs leading to study drug discontinuation. Change in laboratory parameters, vital signs, and ECG results.

Source: https://euclinicaltrials.eu/ctis-public/view/2023-508158-24-00